EU clinical trial 2025-522786-29-00: Randomized, Double-Blinded, Vehicle-Controlled, Crossover Phase 2 Study to Evaluate the Safety, Tolerability, Pharmacokinetics and Pharmacodynamics of Intranasal Cenegermin (Recombinant Human Nerve Growth Factor [rhNGF]) in Pediatric Participants with Spastic Cerebral Palsy (CP).
Protocol code: NGF-CP-201
Sponsor: Dompe' Farmaceutici S.p.A. (Pharmaceutical company). Phase: Therapeutic exploratory (Phase II). Countries: Italy (ongoing, recruiting).
Therapeutic area(s): Diseases [C] - Nervous System Diseases [C10]
Gender: Female, Male. Age: 0-17 years. Enrolment: 60.
Status: Ongoing, recruiting. Start date (EU): 2026-01-07. Decision date: 2025-12-11. Results received: No. Last updated: 2026-07-23.
Decision dates by country: IT: 2025-12-17

Condition(s): Spastic Cerebral Palsy
Product: The placebo for investigational lyophilized cenegermin Drug Product is the same as the Drug Product with the exception that it does not contain cenegermin., Cenegermin

Primary endpoint: Incidence of treatment-emergent adverse events following the first administration of investigational product.
Endpoint(s): 2. Change in the MAS score, PROM, GMFM-66 & GMFCS-E&R., 4. NGF serum concentrations., 1.Incidence of treatment-emergent SAEs, treatment-emergent nonserious AEs, study discontinuation for tolerability reasons. Change on Vital signs, Weight and height, Physical examinations, Clinical laboratory assessments, 12-lead ECG results, EEG results., 3. Change in daily activities & Social/cognitive domains, as assessed by PEDI-CAT, & in communication function as assessed by the CFCS.

Source: https://euclinicaltrials.eu/ctis-public/view/2025-522786-29-00